EU clinical trial 2024-516141-39-00: EFFECT OF ONCE VS TWICE DAILY ADMINISTRATION OF CORTICOSTEROIDS ON BLOOD GLUCOSE IN PATIENTS WITH ANCA-VASCULITIS MEASURED BY CONTINUOUS BLOOD GLUCOSE MONITORING - A PILOT STUDY
Sponsor: Medical University Of Graz (Educational Institution). Phase: Phase III and phase IV (Integrated). Countries: Austria (ongoing, recruiting).
Therapeutic area(s): Diseases [C] - Immune System Diseases [C20]
Gender: Female, Male. Age: 18-64 years, 65+ years. Enrolment: 10.
Status: Ongoing, recruiting. Start date (EU): 2020-09-25. Decision date: 2024-11-18. Results received: No. Last updated: 2024-11-18.

Condition(s): anti-neutrophil cytoplasmic antibody (ANCA)-associated vasculitides, rapid-progressive glomerulonephritides (RPGN)
Product: Aprednislon 1 mg Tabletten

Primary endpoint: Mean time in target range (70-180mg/dl) measured by blinded continuous glucose measurement (CGM).
Endpoint(s): Number and percent of glucose values (CGM, BG) in the following ranges: 0-<40mg/dl (blood glucose only), 40-<70mg/dl, 70-<100mg/dl, 100-<140mg/dl, 140-<180mg/dl, 180-<300mg/dl, ≥300mg/dl, Time of glucose values (CGM, BG) in the following ranges: 0-<40mg/dl (blood glucose only), 40-<70mg/dl, 70-<100mg/dl, 100-<140mg/dl, 140-<180mg/dl, 180-<300mg/dl, ≥300mg/dl, Average daily blood glucose based on preprandial and bedtime glucose values: total and per treatment day, Mean blood glucose before the respective times: before breakfast, before lunch, before dinner, at bedtime, Mean blood glucose before start of study during in-patient stay, Number of insulin injections per day, Relevant concomitant medication during inpatient stay (corticosteroids, parenteral nutrition, oral antidiabetics), Relevant diabetes medication for discharge from inpatient care (insulin therapy - type and dose, oral antidiabetics), HbA1c, Sex, Age, Additionally affected organs, Antibody titer (ANCA, anti-GBM, anti-ds-DNS,..) at initial diagnosis and during course of disease, CRP at initial diagnosis and during course of treatment, Leukocytes at initial diagnosis and during course of disease, Thrombocytes at initial diagnosis and during course of disease, GFR at initial diagnosis and during course of disease, Creatinine at initial diagnosis and during course of disease, Protein and albuminuria at initial diagnosis and during course of disease, Urinary sediment at initial diagnosis and in the course of the disease, Therapy after initial diagnosis and during course (e.g. switch to rituximab), Birmingham Vasculitis Score (BVAS) on discharge, Quality of life measured by the SF-36 and KDQOL questionnaire

Source: https://euclinicaltrials.eu/ctis-public/view/2024-516141-39-00